EU clinical trial 2024-511344-11-00: A Phase 1 study to test for safety and activity of an oral investigational drug, in patients with AML or other blood or bone marrow malignacies with an IDH1 mutation.
Protocol code: AG120-C-001
Sponsor: Institut De Recherches Internationales Servier IRIS (Pharmaceutical company). Phase: Human Pharmacology (Phase I)- First administration to humans. Countries: France (ongoing, recruiting).
Therapeutic area(s): Diseases [C] - Neoplasms [C04]
Gender: Female, Male. Age: 18-64 years, 65+ years. Enrolment: 72.
Status: Ongoing, recruiting. Start date (EU): 2014-07-18. Decision date: 2024-08-14. Results received: No. Last updated: 2025-05-02.

Condition(s): AG-120 is being investigated for the treatment of patients with advanced hematologic malignancies that are IDH1 mutation.

Source: https://euclinicaltrials.eu/ctis-public/view/2024-511344-11-00